EU clinical trial 2024-512964-73-00: A Phase II, Multi-center, Open-Label Study to Assess Safety, Tolerability, Efficacy and Pharmacokinetics of R3R01 in Alport Syndrome Patients with Uncontrolled Proteinuria on ACE/ARB Inhibition and in Patients with Primary Steroid-Resistant Focal Segmental Glomerulosclerosis
Protocol code: R3R01-ASFSGS-201
Sponsor: River 3 Renal Corp. (Pharmaceutical company). Phase: Therapeutic exploratory (Phase II). Countries: France (ended), Belgium (ended), Netherlands (ended), Germany (ended).
Therapeutic area(s): Not possible to specify
Gender: Female, Male. Age: 0-17 years, 18-64 years. Enrolment: 20.
Status: Ended. Start date (EU): 2023-01-18. End date (EU): 2025-08-19. End date: 2025-08-20. Decision date: 2024-06-25. Results received: No. Last updated: 2025-02-07.
Decision dates by country: FR: 2024-07-04, NL: 2024-06-26, BE: 2024-06-25, DE: 2024-06-26

Condition(s): Alport Syndrome (AS) and Primary Steroid-Resistent Focal Segmental Glomerulosclerosis (FSGS)

Primary endpoint: Safety and tolerability endpoints will be assessed by occurrence of adverse events (AE), changes in physical examinations, vital signs, ECGs and clinical laboratory parameters., For AS patients: The change from baseline in UPCR at 12 weeks for all patients with AS., For FSGS patients: The change from baseline in UPCR at 12 weeks for all patients with FSGS.
Endpoint(s): For all patients: • Change in quality-of-life assessment from baseline to end of treatment and to the end of the follow-up period by cohort., Population pharmacokinetic analysis to derive primary PK parameters (absorption rate (ka), apparent Clearance (Cl/F), apparent Volume of distriburion (V/F)), and secondary PK parameters (maximum concentration (Cmax), time of Cmax (tmax), minimum plasma concentrations (Cmin), area under the concentration time curve, elimination half-life (t1/2)., For AS patients: • Number of AS patients with complete response, a partial response for proteinuria (categorical assessment) at weeks 4, 8, 12, 16, 20 and 24., For FSGS patients: • Number of FSGS patients with complete remission, a partial remission or a modified partial remission for proteinuria (categorical assessment) at weeks 4, 8, 12, 16, 20 and 24.

Source: https://euclinicaltrials.eu/ctis-public/view/2024-512964-73-00